EU clinical trial 2023-505892-56-00: Long-term Study to Assess the Safety and Effectiveness of NMRA-335140 in Participants with Major Depressive Disorder
Protocol code: NMRA-335140-501
Sponsor: Neumora Therapeutics Inc. (Pharmaceutical company). Phase: Therapeutic confirmatory (Phase III). Countries: Bulgaria (ongoing, recruitment ended), Czechia (ongoing, recruitment ended), Sweden (ongoing, recruitment ended), Poland (ongoing, recruitment ended), Germany (ongoing, recruitment ended), Finland (ongoing, recruitment ended), France (ongoing, recruitment ended).
Therapeutic area(s): Psychiatry and Psychology [F] - Mental Disorders [F03]
Gender: Female, Male. Age: 18-64 years. Enrolment: 495.
Status: Ongoing, recruitment ended. Start date (EU): 2024-09-30. Decision date: 2024-06-25. Results received: No. Last updated: 2026-06-02.
Decision dates by country: DE: 2024-06-26, FR: 2024-06-28, FI: 2024-06-27, CZ: 2024-07-08, SE: 2024-06-25, PL: 2024-07-05, BG: 2024-07-01

Condition(s): Major Depressive Disorder
Product: NMRA-335140

Primary endpoint: Safety and tolerability assessments based on adverse events (AEs), clinical laboratory parameters, electrocardiograms (ECGs), vital signs, physical examinations, ophthalmologic examination and corneal specular microscopy (CSM), Columbia Suicide Severity Rating Scale (C-SSRS), and Change in Sexual Functioning Questionnaire-14 (CSFQ-14).
Endpoint(s): Change from baseline in Montgomery-Åsberg Depression Rating Scale (MADRS) total score over time., Change from baseline in the Snaith-Hamilton Pleasure Scale (SHAPS) total score over time., Change from baseline in the Patient Health Questionnaire-9 (PHQ-9) total score over time., Change from baseline in PHQ-9 Anhedonia Item #1 over time., Change from baseline in the Hamilton Anxiety Rating Scale (HAM-A) total score over time., Change from baseline in the Clinical Global Impression of Severity (CGI-S) score over time, Value at each timepoint assessed in the Clinical Global Impression of Improvement (CGI-I) score., Percentage of participants whose MADRS total score decreased by greater than or equal to 50% from baseline over time., Percentage of participants whose MADRS total score decreased to 10 or less over time., Change from baseline in the Sheehan Disability Scale (SDS) over time.

Source: https://euclinicaltrials.eu/ctis-public/view/2023-505892-56-00